EU clinical trial 2023-509134-19-00: A Multicenter, Randomized, Double-Masked, Vehicle-Controlled Study to Assess the Safety and Efficacy of SYD-101 Ophthalmic Solution for the Treatment of Myopia in Children
Protocol code: SYD-101-001
Sponsor: Sydnexis Inc. (Pharmaceutical company). Phase: Therapeutic confirmatory (Phase III). Countries: Slovakia (ended), Austria (ended).
Therapeutic area(s): Diseases [C] - Eye Diseases [C11]
Gender: Female, Male. Age: 0-17 years, 18-64 years. Enrolment: 70.
Status: Ended. Start date (EU): 2019-10-23. End date (EU): 2025-02-26. End date: 2025-05-01. Decision date: 2024-04-18. Results received: Yes. Last updated: 2024-10-02.
Decision dates by country: AT: 2024-04-30, SK: 2024-04-18

Condition(s): Myopia
Product: SYD-101, Vehicle (control) is similar to SYD-101, except that it does not contain active drug., SYD-101

Primary endpoint: Mean annual progression rate of myopia through month 24, Evaluation of AEs and SAEs
Endpoint(s): Proportion of participants with myopic progression >0.75 D at or before Month 24, Proportion of participants with annual myopia progression rate through Month 24 ≤0.50 D/year, Proportion of participants with annual myopia progression rate through Month 24 ≤0.25 D/year, Proportion of participants with increase of myopia of >0.50 D at or before Month 24, Time to progression of myopia of >0.75 D through Month 24, Mean annual progression rate using Month 24 data on Subgroup of participants with refractive history of progression ≥ 0.5D, Mean annual progression rate using Month 24 data on Subgroup of participants with refractive history of progression ≥ 0.75D, Mean change from baseline in axial length at Month 24 (at sites with the requisite equipment; at least 50% of participants), Mean change from baseline in SE at Month 48 (ie, 12 months after randomized withdrawal), Mean time spent on various activities will be solicited via questionnaire, Proportion of agreement to QOL statements, Changes from baseline in vital sign measurements, Mean change from baseline in pupil diameter. Mean change from baseline in binocular accommodative amplitude . Changes from baseline in findings detected by best-corrected visual acuity (BCVA), biomicroscopy, intraocular pressure (IOP), and ophthalmoscopy. Changes from baseline in corneal endothelial cell count (selected sites only; approximately 25% of study participants)., Tolerability to the masked study drug will be solicited via questionnaire, Pregnancy test results (female participants of childbearing potential only)

Source: https://euclinicaltrials.eu/ctis-public/view/2023-509134-19-00